EU clinical trial 2022-501519-15-00: Optimisation of lymph node fine needle aspiration to study pneumococcal vaccine-induced immunity
Sponsor: Leiden University Medical Center (Hospital/Clinic/Other health care facility). Phase: Therapeutic exploratory (Phase II). Countries: Netherlands (ongoing, recruiting).
Therapeutic area(s): Phenomena and Processes [G] - Immune system processes [G12]; Phenomena and Processes [G] - Immune System Phenomena [G13]; Analytical, Diagnostic and Therapeutic Techniques and Equipment [E] - Investigative Techniques [E05]
Gender: Female, Male. Age: 18-64 years. Enrolment: 5.
Status: Ongoing, recruiting. Start date (EU): 2023-04-01. Decision date: 2023-02-02. Results received: No. Last updated: 2024-06-20.

Condition(s): Healthy volunteers
Product: Apexxnar suspension for injection in pre-filled syringe Pneumococcal polysaccharide conjugate vaccine (20-valent, adsorbed), Prevenar 13 suspension for injection in single dose vial pneumococcal polysaccharide conjugate vaccine (13-valent, adsorbed)

Primary endpoint: Percentage of (polysaccharide-specific) germinal centre B cells in lymph node aspirates, as determined by spectral flow cytometry
Endpoint(s): Kinetics of the proportion of T follicular helper cells in lymph node aspirates, Dynamics in B cell and T cell phenotype in lymph node aspirates, including immunoglobulin class switching and activation/differentiation markers, Deep immunophenotyping of B cells and T cells in peripheral blood by spectral flow cytometry, Timing of seroconversion in peripheral blood, Cytokine concentration in peripheral blood and lymph node aspirate

Source: https://euclinicaltrials.eu/ctis-public/view/2022-501519-15-00